EU clinical trial 2024-517981-40-00: A randomized placebo-controlled double-blind phase III two-arm study to investigate the reduction of Monthly Migraine Days (MMDs) over 12 weeks of treatment with combination of CGRP mAbs and onabotulinumtoxin A intramuscularly compared with CGRP mAbs and placebo in male and female participants with chronic migraine aged 18-70 years.
Protocol code: NorMig
Sponsor: Oslo University Hospital HF (Hospital/Clinic/Other health care facility). Phase: Therapeutic confirmatory (Phase III). Countries: Norway (ongoing, recruiting).
Therapeutic area(s): Diseases [C] - Nervous System Diseases [C10]
Gender: Female, Male. Age: 18-64 years, 65+ years. Enrolment: 450.
Status: Ongoing, recruiting. Start date (EU): 2025-06-06. Decision date: 2025-05-13. Results received: No. Last updated: 2025-10-14.

Condition(s): Chronic Migraine
Product: AJOVY 225 mg solution for injection in pre-filled pen, Aimovig 70 mg solution for injection in pre-filled pen, Emgality 120 mg solution for injection in pre-filled pen, Natriumklorid B. Braun 9 mg/ml oppløsningsvæske til parenteral bruk, BOTOX 200 Allergan-enheter Pulver til injeksjonsvæske, oppløsning

Primary endpoint: Reduction of Monthly Migraine Days (MMDs) over 12 weeks of treatment with the study medication
Endpoint(s): Reduction of Monthly Headache Days (MHDs) over 12 weeks of treatment with the study medication, Monthly number of days with rescue medication over 12 weeks of treatment with the study medication., Number of treatment responders (≥ 50%, ≥75% and 100 % reduction in MHD and MMDs over 12 weeks of treatment) at 12 weeks post-randomisation., Number of weekly migraine days from baseline to 12 months post-randomization., Total number of hours at moderate or severe pain over 12 weeks of treatment., Number of treatment responders (≥ 30% reduction in mean MHDs over 12 weeks of treatment) at 12 weeks post-randomization., Number of crystal-clear headache-free days after 12 weeks of treatment with the study medication., Percentage of patients fulfilling the ICHD-3 diagnostic criteria for MOH over 12 weeks of treatment., Number of patients completing the trial and number of dropouts., Change in MIDAS over 12 weeks of treatment with the study medication., Change in HADS-A and HADS-D score over 12 weeks of treatment with the study medication., Change in Bergen Insomnia Scale over 12 weeks of treatment with the study medication, Change in Fatigue Score over 12 weeks of treatment with the study medication, Change in Mig-SCOG score over 12 weeks of treatment with the study medication, PGIC sum, Number of days on sick leave from baseline to 12 weeks post-randomization., • Number of treatment related adverse events (AEs) and treatment related serious adverse events (SAEs) over 12 weeks of treatment., Costs and Quality of life measured by EQ-5D-5L before treatment initiation, and 12 weeks after treatment initiation, Absenteeism from work (salary, sick leave, social security). Presenteeism (lost workplace productivity), Productivity Cost, Treatment duration and dose intensity for trial treatments, adverse events (eCRF). Type and frequency of physician visits, emergency departments, general practitioner visits, hospitalizations. Other related resource use, including pharmaceuticals, transport, and time.

Source: https://euclinicaltrials.eu/ctis-public/view/2024-517981-40-00